EU clinical trial 2023-508522-95-00: EPIK-P3: A phase II study to evaluate the long-term safety and efficacy of alpelisib in patients with PIK3CA Related-Overgrowth Spectrum (PROS) who previously participated in Study CBYL719F12002 (EPIK-P1)
Protocol code: CBYL719F12401
Sponsor: Novartis Pharma AG (Pharmaceutical company). Phase: Therapeutic exploratory (Phase II). Countries: Ireland (ongoing, recruitment ended), Spain (ongoing, recruitment ended), France (ongoing, recruitment ended).
Therapeutic area(s): Diseases [C] - Congenital, Hereditary, and Neonatal Diseases and Abnormalities [C16]
Gender: Female, Male. Age: 0-17 years, 18-64 years, 65+ years. Enrolment: 39.
Status: Ongoing, recruitment ended. Start date (EU): 2022-01-27. Decision date: 2024-03-21. Results received: No. Last updated: 2026-06-10.
Decision dates by country: FR: 2024-04-05, IE: 2024-03-21, ES: 2024-03-21

Condition(s): PIK3CA-Related Overgrowth Spectrum (PROS)
Product: BYL719, BYL719, BYL719

Primary endpoint: Incidence of new or worsening grade ≥3 treatment emergent AEs (by system organ class and preferred term)
Endpoint(s): Retrospective Period Only - Incidence, type and severity per common terminology criteria for AEs (CTCAE) v4.03 criteria, causality assessments of AEs, and other safety data including changes in laboratory values, vital signs and assessment of cardiac function., Prospective Period Only - Incidence, type and severity per CTCAE v4.03 criteria, causality assessments of AEs, and other safety data including changes in laboratory values, vital signs and assessment of cardiac function. Additionally, for this period only, growth, bone/dental development and sexual maturation (for applicable age) will be assessed., Investigator assessment of lesion response as improved, stable or worsened., Incidence of PROS-related symptoms and complications/comorbidities among participants with symptoms and complications/comorbidities., Number of healthcare visits/hospitalizations due to PROS., Description of medications and non-drug therapies received -PROS-related treatment(s) other than alpelisib -Medication(s) (e.g., concomitant PROS-related medications including medication for the management of PROS related complications as well as medications to manage complications secondary to alpelisib) -Non-drug treatment(s) -Alpelisib treatment -PROS-related surgeries

Source: https://euclinicaltrials.eu/ctis-public/view/2023-508522-95-00